EU clinical trial 2024-514449-12-00: A Phase 2b, Randomized, Double-Mask, Placebo-Controlled, Study to Evaluate the Safety, Pharmacokinetics and Efficacy of Linsitinib in Subjects with Active, Moderate to Severe Thyroid Eye Disease (TED)
Protocol code: VGN-TED-301
Sponsor: Sling Therapeutics Inc. (Pharmaceutical company). Phase: Therapeutic exploratory (Phase II). Countries: Italy (ended), Spain (ended).
Therapeutic area(s): Diseases [C] - Eye Diseases [C11]
Gender: Female, Male. Age: 18-64 years, 65+ years. Enrolment: 18.
Status: Ended. Start date (EU): 2022-11-04. End date (EU): 2025-09-26. Decision date: 2024-07-08. Results received: No. Last updated: 2025-10-27.
Decision dates by country: ES: 2024-07-08, IT: 2024-07-15

Condition(s): Disease (TED)
Product: placebo tablets are formulated to match the physical characteristics of the active tablets. the placebo drug product is a tablet formulation compressed from a direct powder blend containing microcrystalline cellulose, lactose monohydrate, and magnesium stearate.

Primary endpoint: Proptosis responder rate at Week 24.
Endpoint(s): Change from Baseline to Week 24 in proptosis measurement in the primary study eye., Overall responder rate in Clinical Activity Scale (CAS) or proptosis in the contralateral non-study eye at Week 24., Percentage of subjects with a CAS value of 0 or 1 at Week 24 in the primary study eye., Mean change from Baseline to Week 24 in the Graves’ Ophthalmopathy Quality of Life (GO-QoL) questionnaire overall score.

Source: https://euclinicaltrials.eu/ctis-public/view/2024-514449-12-00